EU clinical trial 2023-509025-41-00: A study to investigate the similarity of two different Tiotropium inhalers in healthy volunteers.
Protocol code: CIX23001
Sponsor: CCDRD Cooperative Clinical Drug Research and Development AG, Invox Belgium (Pharmaceutical company). Phase: Human Pharmacology (Phase I)- Bioequivalence Study. Countries: Bulgaria (ended).
Therapeutic area(s): Diseases [C] - Respiratory Tract Diseases [C08]
Gender: Female, Male. Age: 18-64 years. Enrolment: 40.
Status: Ended. End date (EU): 2025-11-26. Decision date: 2024-10-07. Results received: No. Last updated: 2024-12-05.
Decision dates by country: BG: 2024-12-05

Condition(s): No therapeutic indication in the current trial with healthy volunteers.

Source: https://euclinicaltrials.eu/ctis-public/view/2023-509025-41-00